EU clinical trial 2023-503297-20-00: Implementation and evaluation of Pressurized Intrathoracic Aerosol Chemotherapy (PITAC) for the treatment of patients with malignant pleural effusion. A Danish phase I
Sponsor: Odense University Hospital (Hospital/Clinic/Other health care facility). Phase: Human Pharmacology (Phase I)- Other. Countries: Denmark (ongoing, recruiting).
Therapeutic area(s): Diseases [C] - Neoplasms [C04]
Gender: Female, Male. Age: 18-64 years, 65+ years. Enrolment: 20.
Status: Ongoing, recruiting. Start date (EU): 2023-09-15. Decision date: 2023-05-24. Results received: No. Last updated: 2025-03-21.

Condition(s): Malignant pleural effusion

Source: https://euclinicaltrials.eu/ctis-public/view/2023-503297-20-00